EU clinical trial 2022-501372-25-00: FILOAML-RR-01-OGILAR: Open-label, phase 2 study investigating the efficacy and safety of the addition of oral-azacitidine to salvage treatment by gilteritinib in subjects ≥18 years of age with relapsed/refractory FLT3-mutated acute myeloid leukemia
Sponsor: French Innovative Leukemia Organization (Laboratory/Research/Testing facility). Phase: Therapeutic exploratory (Phase II). Countries: France (ongoing, recruitment ended).
Therapeutic area(s): Diseases [C] - Hemic and Lymphatic Diseases [C15]
Gender: Female, Male. Age: 18-64 years, 65+ years. Enrolment: 33.
Status: Ongoing, recruitment ended. Start date (EU): 2024-01-10. Decision date: 2023-05-11. Results received: No. Last updated: 2026-05-28.

Condition(s): Patients aged 18 years and older with relapsed or refractory FLT3 mutated acute myeloid leukemia
Product: azacitidine, azacitidine, Xospata 40 mg film-coated tablets

Primary endpoint: CRc is defined by addition of best response during the first 3-months treatment, CR is defined by presence of regenerating hematopoietic cells in the bone marrow and achievement of a morphologic leukemia-free state (MLFS) with absolute neutrophil count (ANC) ≥1 × 109/l, platelet count ≥100 × 109/l, normal bone marrow differential with <5% blasts, and red blood cell (RBC)/platelet transfusion independence with no evidence of extramedullary AML according to Döhner et al. 1, CRi defined by achievement of all CR criteria except for hematologic recovery with residual neutropenia (ANC <1 × 109/l) with or without RBC/platelet transfusion independence according to Perl et al. 2, CRp defined by achievement of all CR criteria except for platelet recovery (platelet count <100 × 109/l) according to Perl et al. 2
Endpoint(s): Safety and tolerability will be defined by: • % of early deaths (ED) at Day 30 • incidence and relatedness of adverse events (AE) according to CTCAE v5.0, Best response during the first 6-months treatment among: • CRh is defined by bone marrow blasts <5% with partial hematologic recovery defined as ANC ≥0.5 × 109/l and platelet count ≥50 × 109/l, with no evidence of extramedullary leukemia and cannot be classified as CR, according to Perl et al. 2, Best response during the first 6-months treatment among:• PR is defined by presence of regenerating normal hematopoietic cells in bone marrow with evidence of peripheral recovery with no (or only a few regenerating) circulating blasts and with a ≥50% decrease in the number of blasts in the bone marrow aspirate with total marrow blasts between 5% and 25%. A value of ≤5% blasts is also considered a PR if Auer rods are present according to Döhner et al. 1, Best response during the first 6-months treatment among: • MLFS is defined by a bone marrow blasts <5%; absence of blasts with Auer rods; absence of extramedullary disease; no hematologic recovery required according to Döhner et al. 1, Best response during the first 6-months treatment among: • SD is defined as absence of CR, CRi, CRp, CRh, PR or MLFS without progressive disease for at least 3 months according to Döhner et al. 1 • CR/CRi/CRp/CRh/MLFSMRD- is defined as a CR/CRi/CRp/CRh/MLFS with negativity for a genetic marker by RT-qPCR, or CR/CRi/CRp/CRh/MLFS with <10-3 AML cells by MFC according to Döhner et al. 3, Analysis of: • % of per protocol HSCT, % of HSCT in CRc, % of patients receiving gilteritinib at day +100 post HSCT • OS, EFS, RFS, CIR and NRM will be defined according to Cheson et al. 4

Source: https://euclinicaltrials.eu/ctis-public/view/2022-501372-25-00